EU clinical trial 2024-519750-36-00: The STELLAR trial: Fluorescence-guided surgery in laryngeal- and hypopharyngeal cancer: a feasibility trial
Protocol code: NL74742.078.20
Sponsor: Erasmus Universitair Medisch Centrum Rotterdam (Erasmus MC) (Hospital/Clinic/Other health care facility). Phase: Phase I and Phase II (Integrated)- First administration to humans. Countries: Netherlands (ongoing, recruiting).
Therapeutic area(s): Diseases [C] - Neoplasms [C04]
Gender: Female, Male. Age: 18-64 years, 65+ years. Enrolment: 27.
Status: Ongoing, recruiting. Start date (EU): 2026-03-31. Decision date: 2024-12-16. Results received: No. Last updated: 2026-02-12.

Condition(s): Squamous cell carcinoma of the larynx and hypopharynx
Product: cRGD-ZW800-1

Primary endpoint: The primary study endpoint of WP-1 is the tumor-to-background ratio (TBR) of laryngeal or pharyngeal tumours with fluorescence imaging after cRGD-ZW800-1 administration. The primary endpoint of WP-II is the number of clear resection margins

Source: https://euclinicaltrials.eu/ctis-public/view/2024-519750-36-00